EU clinical trial 2024-513652-15-00: ARTEGENE - A Phase 1/2 Open Label non randomized Study, multicentric, single arm evaluating the Safety and Efficacy of Gene Therapy of the severe combined immunodeficiency (SCID) caused by mutations in the human DCLRE1C gene (Artemis) by transplantation of a single dose of autologous CD34+ cells transduced ex vivo with the G2ARTE lentiviral vector expressing the DCLRE1C cDNA
Protocol code: D20180302
Sponsor: Assistance Publique Hopitaux De Paris (Hospital/Clinic/Other health care facility). Phase: Phase I and Phase II (Integrated)- First administration to humans. Countries: France (ongoing, recruiting).
Therapeutic area(s): Diseases [C] - Hemic and Lymphatic Diseases [C15]
Gender: Female, Male. Age: 0-17 years. Enrolment: 7.
Status: Ongoing, recruiting. Start date (EU): 2023-07-19. Decision date: 2024-09-27. Results received: No. Last updated: 2026-06-03.

Condition(s): Severe Combined Immuno-Deficiency (SCID) caused by biallelic mutations in the Artemis gene (DCLRE1C)
Product: ARTEGENE

Primary endpoint: Safety and efficacy of ARTEGENE drug product
Endpoint(s): End of ongoing infection before the transplantation, Kinetics of immune reconstitution, Adverse event will be measured using CTCAE

Source: https://euclinicaltrials.eu/ctis-public/view/2024-513652-15-00